EU clinical trial 2023-509339-17-00: A Study to Learn About the Study Medicine Called PF-07054894 in People of Japanese Origin
Protocol code: C4151006
Sponsor: Pfizer Inc. (Pharmaceutical company). Phase: Human Pharmacology (Phase I)- Other. Countries: Belgium (ended).
Therapeutic area(s): Diseases [C] - Immune System Diseases [C20]
Gender: Female, Male. Age: 18-64 years, 65+ years. Enrolment: 6.
Status: Ended. Start date (EU): 2024-04-15. End date (EU): 2024-07-02. End date: 2024-07-03. Decision date: 2024-03-15. Results received: No. Last updated: 2024-05-08.

Condition(s): Inflammatory bowel disease

Source: https://euclinicaltrials.eu/ctis-public/view/2023-509339-17-00